EU clinical trial 2025-523678-17-00: Phase 1b study to assess the safety and tolerability of SR-878 in patients with rheumatoid arthritis
Protocol code: SR-878-01-002
Sponsor: SciRhom GmbH (Pharmaceutical company). Phase: Human Pharmacology (Phase I)- Other. Countries: Romania (authorised, recruitment pending).
Therapeutic area(s): Diseases [C] - Immune System Diseases [C20]
Gender: Female, Male. Age: 18-64 years. Enrolment: 12.
Status: Authorised, recruitment pending. Decision date: 2026-04-24. Results received: No. Last updated: 2026-04-24.

Condition(s): rheumatoid arthritis

Source: https://euclinicaltrials.eu/ctis-public/view/2025-523678-17-00